EU clinical trial 2025-520762-22-00: Hormonal Receptor (HR)-positive HER2 negative breast cancer patients treated with preoperative ELacestrant and PULSAR adaptive radiotherapy: a phase II study
Protocol code: HELP Trial
Sponsor: Fondazione Radioterapia Oncologica Onlus (Hospital/Clinic/Other health care facility). Phase: Therapeutic exploratory (Phase II). Countries: Italy (ongoing, recruiting).
Therapeutic area(s): Diseases [C] - Neoplasms [C04]
Gender: Female, Male. Age: 18-64 years, 65+ years. Enrolment: 21.
Status: Ongoing, recruiting. Start date (EU): 2025-09-16. Decision date: 2025-07-14. Results received: No. Last updated: 2025-07-14.

Condition(s): Patients with HR-positive, HER2-negative, non-metastatic node positive BC eligible for neoadjuvant treatment (clinical stage II-III)
Product: ELACESTRANT

Primary endpoint: Reported adverse events (AEs) and serious adverse events (SAEs), Changes from Baseline in laboratory parameters (hematology, biochemistry, coagulation, and urinalysis), physical examinations, vital signs, and electrocardiograms (ECGs) during the Treatment and Follow-up periods.
Endpoint(s): Tumor Pathological complete response (pCR), defined as the absence of residual invasive cancer on hematoxylin and eosin evaluation of the complete resected breast specimen and all sampled regional lymph nodes following completion of neoadjuvant systemic therapy (i.e., ypT0/Tis ypN0 in the current American Joint Committee on Cancer (AJCC) system)., Residual cancer burden (RCB) as a determinant of the extent of residual disease in post-surgery. Six variables are included in the formula. An RCB index value can also be calculated and involves the categorization into one of four RCB classes (RCB 0 or pCR, RCB I or near pCR, RCB II, RCB III)., Event-free survival (EFS), defined as the time from first dose of PULSAR and Elacestrant to any of the following events: progression of disease that precludes surgery, local or distant recurrence, or death due to any cause up to the end of the safety follow-up at 12 months., Clinical efficacy based on available RECIST 1.1 assessments: Objective response rate (ORR): proportion of patients having a best overall response (BOR) of complete response (CR) or partial response (PR) relative to assessment at the Screening visit, Residual nodal burden (RNB), Nodal pathologic complete response ([n]pCR) rate, Local Control (LC) rate, Overall Survival (OS), defined as time from the first PULSAR and Elacestrant administration to last follow up or death for any reason, Invasive disease-free survival (iDFS), defined as the time from first dose of PULSAR and Elacestrant until local or distant recurrence or death due to any cause up to the end of the safety follow-up at 12 month., Exploratory: Metabolomic and transcriptomic assessment on tissue before (diagnostic biopsy) and after treatment (surgical specimen). Metabolomic will be performed in house using an LC-MS based approach using our new platform (LC-MS Agielnt Q-TOF 6546). Additional transcriptomic analysis will be performed., Exploratory: Evaluation of the immune environment on tissue before (diagnostic biopsy) and after treatment (surgical specimen) (CD8, CD4, RBP-J CD163 and CD68 on immunohistochemistry)., Exploratory: ctDNA analysis on blood samples at baseline, 12 weeks from first PULSAR administration and at EoT visit.

Source: https://euclinicaltrials.eu/ctis-public/view/2025-520762-22-00